EU clinical trial 2023-505012-38-00: A study to test how a new long-acting insulin works in the body of patients with type 2 diabetes during exercise and prolonged fasting.
Protocol code: NN1436-7615
Sponsor: Novo Nordisk A/S (Pharmaceutical company). Phase: Human Pharmacology (Phase I)- Other. Countries: Austria (ended).
Therapeutic area(s): Diseases [C] - Nutritional and Metabolic Diseases [C18]
Gender: Female, Male. Age: 18-64 years, 65+ years. Enrolment: 30.
Status: Ended. Start date (EU): 2024-02-21. End date (EU): 2025-04-14. Decision date: 2024-02-12. Results received: No. Last updated: 2025-02-23.
Decision dates by country: AT: 2024-05-06

Condition(s): Type 2 diabetes

Source: https://euclinicaltrials.eu/ctis-public/view/2023-505012-38-00